EU clinical trial 2024-514596-18-00: An open-label, multi-center, phase 1/2 study to assess safety, cellular kinetics and exploratory efficacy of rapcabtagene autoleucel in participants with difficult-to-treat rheumatoid arthritis and severe, refractory Sjogren's disease with organ involvement
Protocol code: CYTB323M12101B
Sponsor: Novartis Pharma AG (Pharmaceutical company). Phase: Phase I and Phase II (Integrated)- Other. Countries: Germany (ongoing, recruiting), Spain (ongoing, recruiting), France (ongoing, recruiting), Hungary (authorised, recruitment pending), Italy (authorised, recruitment pending).
Therapeutic area(s): Diseases [C] - Immune System Diseases [C20]
Gender: Female, Male. Age: 18-64 years, 65+ years. Enrolment: 27.
Start date (EU): 2025-06-20. Decision date: 2025-05-02. Results received: No. Last updated: 2026-05-12.
Decision dates by country: DE: 2025-05-02, FR: 2025-05-06, ES: 2025-05-07, HU: 2026-05-11, IT: 2026-05-12

Condition(s): Difficult to treat rheumatoid arthritis, Severe, refractory Sjogren’s disease with organ involvement
Product: FLUDARABINE PHOSPHATE, YTB323, CYCLOPHOSPHAMIDE, TOCILIZUMAB

Primary endpoint: Safety parameters include vital signs, adverse events, laboratory parameters and ECG evaluation
Endpoint(s): Rapcabtagene autoleucel transgene concentrations by qPCR over time in peripheral blood; cellular kinetics parameters (Cmax, AUC, Tmax, T1/2, Clast, Tlast)

Source: https://euclinicaltrials.eu/ctis-public/view/2024-514596-18-00